EU clinical trial 2025-521692-31-00: A Phase 3, Open-label, Multicenter Continuation Trial to Evaluate the Long-term Safety and Efficacy of Mezagitamab Subcutaneous Injection in Adults with Chronic Primary Immune Thrombocytopenia
Protocol code: TAK-079-3003
Sponsor: Takeda Development Center Americas Inc. (Pharmaceutical company). Phase: Therapeutic confirmatory (Phase III). Countries: Bulgaria (ongoing, recruiting), Spain (ongoing, recruiting), Netherlands (authorised, recruitment pending), Italy (ongoing, recruiting), Poland (authorised, recruitment pending), Greece (authorised, recruiting), Germany (authorised, recruitment pending), France (authorised, recruitment pending), Czechia (authorised, recruitment pending), Croatia (authorised, recruitment pending), Norway (authorised, recruitment pending), Sweden (authorised, recruitment pending).
Therapeutic area(s): Diseases [C] - Hemic and Lymphatic Diseases [C15]
Gender: Female, Male. Age: 18-64 years, 65+ years. Enrolment: 107.
Start date (EU): 2025-12-19. Decision date: 2025-11-04. Results received: No. Last updated: 2026-04-02.
Decision dates by country: BG: 2025-11-05, ES: 2025-11-11, NL: 2025-11-04, PL: 2025-11-07, GR: 2026-02-12, DE: 2026-03-16, FR: 2026-03-25, CZ: 2026-03-20, HR: 2026-03-30, SE: 2026-02-27, IT: 2025-11-05, NO: 2026-03-05

Condition(s): Chronic Primary Immune Thrombocytopenia
Product: Mezagitamab

Primary endpoint: 01. Occurrence of TEAEs and serious TEAEs., 02. Occurrence of TEAEs leading to permanent withdrawal of mezagitamab
Endpoint(s): 01• Duration of platelet response. • Duration between on-demand treatment courses. • Time to initiation of the first on-demand treatment course. • Occurrence of complete response. • Occurrence of ITP remission., 02. Reduction in dose and/or frequency of concomitant ITP medications throughout the trial., 03. Use of rescue therapy., 04. The PK concentration at selected timepoints during and after intervention., 05. Occurrence of ADA and NAb.

Source: https://euclinicaltrials.eu/ctis-public/view/2025-521692-31-00